EU clinical trial 2026-526102-33-00: Multiple-dose, open-label, laboratory blinded, randomized, 2-period, 2-sequence, crossover, steady-state bioequivalence study comparing the Test Product Naproxen sodium 660 mg modified release tablets with the Reference Product Actromadol 660 mg Modified-Release tablets in healthy adult male and female subjects under fed conditions.
Protocol code: CFA-1042-3-26
Sponsor: Laboratorios Cinfa S.A. (Pharmaceutical company). Phase: Human Pharmacology (Phase I)- Bioequivalence Study. Countries: Czechia (ended).
Therapeutic area(s): Not possible to specify
Gender: Female, Male. Age: 18-64 years. Enrolment: 32.
Status: Ended. Start date (EU): 2026-05-11. End date (EU): 2026-06-15. Decision date: 2026-04-24. Results received: No. Last updated: 2026-05-11.

Condition(s): No medical condition

Source: https://euclinicaltrials.eu/ctis-public/view/2026-526102-33-00